EU clinical trial 2023-503813-31-01: C5721002 _ A Randomized, Open-Label, Phase 3 Trial of Tisotumab Vedotin vs Investigator’s Choice Chemotherapy in Second- or Third-Line Recurrent or Metastatic Cervical Cancer
Protocol code: C5721002 / SGNTV-003
Sponsor: Seagen Inc. (Pharmaceutical company). Phase: Therapeutic confirmatory (Phase III). Countries: Sweden (ended), Czechia (ended), Finland (ended), Netherlands (ended), Hungary (ended), Norway (ended), Germany (ended), Italy (ended), Belgium (ended), Austria (ended), Spain (ended), Poland (ended), France (ended).
Therapeutic area(s): Diseases [C] - Neoplasms [C04]
Gender: Female. Age: 18-64 years, 65+ years. Enrolment: 188.
Status: Ended. Start date (EU): 2021-09-17. End date (EU): 2025-11-18. End date: 2026-01-15. Decision date: 2023-12-04. Results received: No. Last updated: 2025-11-19.
Decision dates by country: AT: 2023-12-15, FI: 2023-12-07, NO: 2023-12-08, CZ: 2023-12-06, PL: 2024-01-12, HU: 2023-12-05, FR: 2024-01-09, SE: 2023-12-04, BE: 2023-12-14, NL: 2023-12-04, IT: 2023-12-11, DE: 2023-12-08, ES: 2023-12-12

Condition(s): Second- or Third-Line Recurrent or Metastatic Cervical Cancer
Product: VINORELBINE, MAXIDEX 0.1% w/v, eye drops, suspension, IRINOTECAN, GEMCITABINE, PEMETREXED, TEARS NATURALE II, eye drops, solution., PEMETREXED, HuMax-TF-ADC, Brimonidine Tartrate 0.2% w/v Eye Drops., TOPOTECAN

Primary endpoint: Overall Survival (OS)
Endpoint(s): 1. Progression-free survival (PFS) based on Response Evaluation Criteria In Solid Tumors (RECIST) v1.1 as assessed by the investigator, 2. Confirmed overall response rate (ORR) based on RECIST v1.1 as assessed by the investigator, 3. Time-to-response (TTR) as assessed by the investigator, 4. DOR as assessed by the investigator, 5. Incidence of adverse events (AEs), 6. EQ-5D-3L index, 7. EQ-5D visual analog scale (VAS), 8. EORTC-QLQ-C30, 9. EORTC-QLQ-CX24

Source: https://euclinicaltrials.eu/ctis-public/view/2023-503813-31-01